EU clinical trial 2023-508482-32-00: A Phase 3, randomized, double-blind, placebo-controlled, multicenter study of mavorixafor in participants with congenital and acquired primary autoimmune and idiopathic chronic neutropenic disorders who are experiencing recurrent and/or serious infections.
Protocol code: X4P-001-110
Sponsor: X4 Pharmaceuticals Inc. (Pharmaceutical company). Phase: Therapeutic confirmatory (Phase III). Countries: Spain (ongoing, recruiting), Hungary (ongoing, recruiting), Germany (ongoing, recruiting), Czechia (authorised, recruiting), Romania (ongoing, recruiting), France (ongoing, recruiting), Greece (ongoing, recruiting), Italy (ongoing, recruiting), Portugal (ongoing, recruiting), Belgium (ongoing, recruiting), Ireland (authorised, recruitment pending), Poland (authorised, recruitment pending).
Therapeutic area(s): Diseases [C] - Immune System Diseases [C20]; Diseases [C] - Congenital, Hereditary, and Neonatal Diseases and Abnormalities [C16]
Gender: Female, Male. Age: 0-17 years, 18-64 years, 65+ years. Enrolment: 86.
Start date (EU): 2024-07-22. Decision date: 2024-06-14. Results received: No. Last updated: 2026-06-09.
Decision dates by country: PT: 2024-09-23, ES: 2024-06-14, FR: 2024-09-24, HU: 2024-06-14, BE: 2025-10-22, DE: 2024-06-17, RO: 2024-06-18, IE: 2025-10-22, IT: 2024-09-24, PL: 2025-09-19, GR: 2024-09-25, CZ: 2024-06-17

Condition(s): Neutropenias
Product: Mavorixafor Placebo Capsules, Mavorixafor

Primary endpoint: Annualized infection rate based on infections adjudicated by a BIAC during the 52-week treatment period, 2a: Proportion of ANC responders. An ANC responder is a participant meeting the definition of a positive ANC response for at least 3 out of 6 visits [Weeks 4, 8, 13, 26, 39, and 52] during the 52-week treatment period, where a positive ANC response is defined as: (please see next "ID 3"), 2b: (continued from ID 2) • ANC ≥ 1500 cells/µL, with the exception of participants with baseline ANC < 500 cells/µL • ≥ 2-fold increase in ANC from baseline, for participants with baseline ANC < 500 cells/µL
Endpoint(s): Infection severity based on CTCAE grading, adjudicated by a BIAC during the 52-week treatment period, Infection duration based on duration of infections adjudicated by a BIAC during the 52-week treatment period, Antibiotic use due to infection, characterized by the frequency of antibiotic use during the 52-week treatment period, Oral ulcers, as assessed by presence or absence of ulcers, during the 52-week treatment period, Change from baseline to Week 52/Day 365 in PROMIS SF Fatigue Questionnaire total score

Source: https://euclinicaltrials.eu/ctis-public/view/2023-508482-32-00